EU clinical trial 2023-507718-28-00: Effects of IL-23 inhibition in patients with very early axial spondyloarthritis – evidence for a true disease modification?
Protocol code: EXPLAIN
Sponsor: St. Elisabeth Gruppe GmbH Katholische Kliniken Rhein-Ruhr (Hospital/Clinic/Other health care facility). Phase: Therapeutic exploratory (Phase II). Countries: Germany (ongoing, recruitment ended).
Therapeutic area(s): Diseases [C] - Musculoskeletal Diseases [C05]; Diseases [C] - Immune System Diseases [C20]
Gender: Female, Male. Age: 18-64 years. Enrolment: 20.
Status: Ongoing, recruitment ended. Start date (EU): 2024-12-19. Decision date: 2024-08-16. Results received: No. Last updated: 2026-05-29.

Condition(s): AXIAL SPONDYLOARTHRITIS
Product: Skyrizi 150 mg solution for injection in pre-filled pen

Primary endpoint: Proportion of patients in low disease activity, defined as ASDAS status of <2.1 after 28 weeks of treatment (primary endpoint), assessed 4 weeks after the last injection (week 32 of the study), Proportion of patients who stay in low disease activity for at least 6 months after treatment withdrawal
Endpoint(s): Improvement of patient´s global assessment after 28 weeks of treatment, assessed 4 weeks after the last injection (week 32 of the study), Proportion of patients in inactive disease, defined as ASDAS status of <1.3 at week 32 and at week 56, Improvement in MRI-related inflammatory lesions (quantified by Berlin score for spine and sacroiliac joints) at week 32 and week 56, Proportion of patients with good overall clinical function (ASAS Health Index (HI) ≤ 5) at week 32 and at week 56, Proportion of patients with a major clinical response, defined as a 50% improvement of the initial BASDAI (BASDAI 50) after 28 weeks of treatment, assessed 4 weeks after the last injection (week 32 of the study), Change from baseline in BASMI and BASFI after 28 weeks of treatment, assessed 4 weeks after the last injection (week 32 of the study)

Source: https://euclinicaltrials.eu/ctis-public/view/2023-507718-28-00